EU clinical trial 2023-508689-14-00: A phase III, Multicenter, Randomized, Double-blind Study to Assess Efficacy and Safety of Two Doses of Crizanlizumab versus placebo, with or without Hydroxyurea/Hydroxycarbamide Therapy, in Adolescent and Adult Sickle Cell Disease Patients with Vaso-Occlusive Crises (STAND)
Protocol code: CSEG101A2301
Sponsor: Novartis Pharma AG (Pharmaceutical company). Phase: Therapeutic confirmatory (Phase III). Countries: Netherlands (ended), France (ended), Finland (ended), Belgium (ended), Spain (ongoing, recruitment ended).
Therapeutic area(s): Diseases [C] - Hemic and Lymphatic Diseases [C15]
Gender: Female, Male. Age: 0-17 years, 18-64 years, 65+ years. Enrolment: 31.
Start date (EU): 2019-09-16. Decision date: 2024-04-03. Results received: No. Last updated: 2026-05-28.
Decision dates by country: FI: 2024-04-03, FR: 2024-04-22, NL: 2024-04-04, BE: 2024-04-12, ES: 2024-04-03

Condition(s): Sickle cell disease
Product: SEG101

Primary endpoint: Annualized rate of VOC events leading to healthcare visit in each treatment group over the first year post randomization
Endpoint(s): Annualized rate of all VOCs leading to healthcare visit and treated at home (based on documentation by health care provider following contact with participant) over the first year post randomization, Annualized rate of VOCs managed at home over the first year post randomization, Duration of VOCs leading to healthcare visit over the first year post randomization, Number and percentage of participants free from VOCs leading to healthcare visit in each group over the first year post randomization, The time to first and second VOC calculated respectively as the time from date of randomization until the first and the second VOC leading to healthcare visit over the first year post randomization, Annualized rate of visits to clinic, Emergency room (ER) and hospitalizations, both overall and VOC-related over the first year post randomization, Evolution of albuminuria and ACR over the first year post randomization, PK parameters after the first and fifth dose (e.g., AUC, Cmax, Tmax, half-life), PD parameter (P-selectin inhibition) after the first and fifth dose, Annualized rate of VOCs leading to healthcare visit, Annualized rate of all VOCs leading to healthcare visit and treated at home, Annualized rate of VOCs managed at home, Number, seriousness, severity, and causality assessments of treatment-emergent adverse events, including infections (serious, non-serious and opportunistic infections) and other safety data as considered appropriate, Absolute change from baseline in hemoglobin, Growth and sexual maturity assessment in adolescents (Tanner stage), Immunogenicity: measurement of anti-drug antibodies (ADA) to crizanlizumab

Source: https://euclinicaltrials.eu/ctis-public/view/2023-508689-14-00